EU clinical trial 2025-523709-13-00: Sevoflurane vs. propofol for general Anesthesia in patients with acute ischemic stroke treated with endoVascular treatmEnt (SAVE trial)
Protocol code: IIBSP-SAV-2025-178
Sponsor: Fundacio Institut De Recerca De L'Hospital De La Santa Creu I Sant Pau (Hospital/Clinic/Other health care facility). Phase: Therapeutic confirmatory (Phase III). Countries: Spain (authorised, recruitment pending).
Therapeutic area(s): Analytical, Diagnostic and Therapeutic Techniques and Equipment [E] - Anesthesia and Analgesia [E03]; Diseases [C] - Cardiovascular Diseases [C14]
Gender: Female, Male. Age: 18-64 years, 65+ years. Enrolment: 330.
Status: Authorised, recruitment pending. Decision date: 2026-04-07. Results received: No. Last updated: 2026-04-07.

Condition(s): Acute ischemic stroke
Product: Sevoflurano Baxter 100% líquido para inhalación del vapor EFG, Propofol Fresenius 20 mg/ml emulsión inyectable y para perfusión EFG

Primary endpoint: The primary outcome of the study will be the final infarct volume (FIV), assessed by Fluid-Attenuated Inversion Recovery (FLAIR) sequence on magnetic resonance imaging (MRI) follow-up at 72 hours post-treatment ± 24 hours.

Source: https://euclinicaltrials.eu/ctis-public/view/2025-523709-13-00